EU clinical trial 2023-508760-29-00: A Phase 3, Multicenter, Randomized, Double-Blind, Placebo-Controlled, Parallel Group Study to Evaluate the Efficacy and Safety of Lebrikizumab/LY3650150 in Participants with Chronic Rhinosinusitis with Nasal Polyps on Background Intranasal Corticosteroids
Protocol code: J2T-MC-KGBU
Sponsor: Eli Lilly & Co. (Pharmaceutical company). Phase: Therapeutic confirmatory (Phase III). Countries: Poland (ongoing, recruiting), Belgium (ongoing, recruiting), Spain (ongoing, recruiting), Germany (ongoing, recruiting), Denmark (ongoing, recruiting), Romania (ongoing, recruiting), Bulgaria (ongoing, recruiting), Italy (ongoing, recruiting), Hungary (authorised, recruitment pending), Portugal (authorised, recruitment pending), Finland (authorised, recruitment pending).
Therapeutic area(s): Diseases [C] - Respiratory Tract Diseases [C08]; Diseases [C] - Otorhinolaryngologic Diseases [C09]
Gender: Female, Male. Age: 18-64 years, 65+ years. Enrolment: 269.
Start date (EU): 2024-10-21. Decision date: 2024-07-30. Results received: No. Last updated: 2026-07-20.
Decision dates by country: ES: 2024-07-31, HU: 2025-09-05, BE: 2024-07-30, DE: 2024-08-01, DK: 2024-07-31, BG: 2024-08-02, PT: 2025-09-22, IT: 2024-07-31, PL: 2024-08-04, FI: 2026-05-21, RO: 2024-08-05

Condition(s): Chronic Rhinosinusitis With Nasal Polyps (CRSwNP)
Product: MOMETASONE, Lebrikizumab, Placebo for Lebrikizumab

Primary endpoint: 1. Mean Change From Baseline (CFBL) in Participant Reported Nasal Congestion Score (NCS) Severity, NCS severity is rated by study participants using a 4-point scale (range from 0 to 3), where 0 corresponds to no symptoms and 3 corresponds to severe symptoms. Study participants are asked to record the severity of nasal congestion for the previous 24 hours. This assessment will be collected in the participant eDiary. [Time Frame: Baseline, Week 24], 2. Mean CFBL in Endoscopic Nasal Polyp Score (NPS) The endoscopic NPS is assessed by a centralized, blinded, independent review of nasal endoscopy video recordings. The total score is the sum of the right and left nasal cavity scores. For each nasal cavity, endoscopic NPS is graded based on polyp size from 0 to 4, where 0 = no polyps and 4 = large polyps. [Time Frame: Baseline, Week 24]

Source: https://euclinicaltrials.eu/ctis-public/view/2023-508760-29-00